EU clinical trial 2024-515687-31-01: Clinical study to evaluate the safety of investigational medicinal product called AD-O51.4 in patients with advanced malignancies
Protocol code: ADO-01-24
Sponsor: Adamed Pharma S.A. (Pharmaceutical company). Phase: Human Pharmacology (Phase I)- First administration to humans. Countries: Poland (ongoing, recruiting).
Therapeutic area(s): Diseases [C] - Neoplasms [C04]
Gender: Female, Male. Age: 18-64 years, 65+ years. Enrolment: 84.
Status: Ongoing, recruiting. Start date (EU): 2025-07-09. Decision date: 2025-01-27. Results received: No. Last updated: 2026-06-02.

Condition(s): Patients suffering from cancer without further treatment options.

Source: https://euclinicaltrials.eu/ctis-public/view/2024-515687-31-01